EU clinical trial 2023-503521-19-00: Randomised, double blind, placebo controlled, multicentre study to evaluate the efficacy, safety and tolerability of givinostat in non-ambulant patients with Duchenne Muscular Dystrophy
Protocol code: DSC/14/2357/50
Sponsor: Italfarmaco S.p.A. (Pharmaceutical company). Phase: Therapeutic confirmatory (Phase III). Countries: Netherlands (ongoing, recruiting), Germany (ongoing, recruiting), France (ongoing, recruiting), Italy (ongoing, recruiting), Belgium (ongoing, recruiting), Czechia (authorised, recruitment pending), Spain (authorised, recruiting), Sweden (authorised, recruitment pending), Poland (authorised, recruitment pending).
Therapeutic area(s): Diseases [C] - Musculoskeletal Diseases [C05]
Gender: Male. Age: 0-17 years. Enrolment: 120.
Start date (EU): 2024-02-09. Decision date: 2023-12-05. Results received: No. Last updated: 2026-07-20.
Decision dates by country: PL: 2026-03-27, DE: 2023-12-05, IT: 2023-12-11, SE: 2026-03-10, ES: 2026-03-25, CZ: 2026-04-20, NL: 2023-12-05, FR: 2023-12-06, BE: 2023-12-11

Condition(s): Duchenne muscular dystrophy (DMD)
Product: ITF2357, PLACEBO for GIVINOSTAT hydrochloride monohydrate (ITF2357) 10 mg/mL oral suspension

Primary endpoint: Change of PUL total score at 18 months of treatment of givinostat compared to placebo group
Endpoint(s): •Change from baseline of Peak Expiratory Flow percent predicted (PEF%p) at 18 months of treatment of givinostat compared to placebo group • Change from baseline of Forced Vital Capacity percent predicted (FVC%p) at 18 months of treatment of givinostat compared to placebo group • Cumulative loss of PUL items over 18 months of treatment of givinostat compared to placebo group, •Type incidence and severity of TEAEs •Proportion of patients experiencing TEAEs (baseline to EOS/F-Up) • Changes in vital signs, lab tests, ECG, ECHO •Time to assisted ventilation, rate and severity of respiratory infection and duration and use of antibiotics of givinostat to placebo group •Time to onset of diarrhoea •Height and weight Z-scores

Source: https://euclinicaltrials.eu/ctis-public/view/2023-503521-19-00